EU clinical trial 2023-504487-41-00: A Multicenter, Adaptive, Randomized, Controlled Trial Platform to Evaluate Safety and Efficacy of Strategies and Treatments for Hospitalized Patients with Respiratory Infections: Strategies and Treatments for Respiratory Infections & Viral Emergencies (STRIVE) - Immune Modulation Strategy Trial
Protocol code: INSIGHT 018B
Sponsor: University Of Minnesota (Educational Institution). Phase: Therapeutic confirmatory (Phase III). Countries: Denmark (ended), France (ended), Sweden (ended), Spain (ended), Ireland (ended), Germany (ended), Greece (ended), Poland (ended), Cyprus (ended).
Therapeutic area(s): Diseases [C] - Virus Diseases [C02]; Diseases [C] - Respiratory Tract Diseases [C08]
Gender: Female, Male. Age: 18-64 years, 65+ years. Enrolment: 345.
Status: Ended. Start date (EU): 2023-11-28. End date (EU): 2025-08-11. Decision date: 2023-10-09. Results received: Yes. Last updated: 2025-05-09.
Decision dates by country: DE: 2023-10-12, SE: 2023-10-13, PL: 2023-10-16, DK: 2023-10-09, FR: 2023-10-09, IE: 2023-10-13, GR: 2023-10-09, CY: 2025-05-09, ES: 2023-10-09

Condition(s): COVID-19
Product: normal saline, volume matched to test product; provided by site, ORENCIA 250 mg powder for concentrate for solution for infusion

Primary endpoint: The primary outcome for this trial is called the "Days to Recovery Scale" assessed over 60 days (DRS-60). DRS-60 is a version of the STRIVE clinical recovery scale (CRS) that is described in the master protocol, which combines time to recovery with non-recovered clinical state and death into an ordinal outcome. For this trial, the DRS-60 version of the CRS includes daily bins for time to recovery with additional categories for alive, not-recovered and death.
Endpoint(s): Mortality (proportion of participants who died by Day 60), 3-category ordinal outcome (recovered, alive but not recovered, dead), Time to recovery, Death or new requirement for invasive mechanical ventilation, Safety as measured by composite of death, Serious Adverse Events, protocol-defined anticipated clinical events, grade 3 Adverse Events, grade 4 Adverse Events

Source: https://euclinicaltrials.eu/ctis-public/view/2023-504487-41-00